EU clinical trial 2025-522632-14-00: A Phase 1/2 Study to Evaluate STK-012 as a Single Agent and in Combination Therapy in Subjects with Front-line Advanced NSCLC and Other Selected Indications
Protocol code: STK-012-101
Sponsor: Synthekine Inc. (Pharmaceutical company). Phase: Therapeutic exploratory (Phase II). Countries: Ireland (ongoing, recruiting), Poland (authorised, recruitment pending), Spain (ongoing, recruiting), Italy (authorised, recruiting).
Therapeutic area(s): Diseases [C] - Neoplasms [C04]
Gender: Female, Male. Age: 18-64 years, 65+ years. Enrolment: 56.
Start date (EU): 2026-05-11. Decision date: 2025-12-19. Results received: No. Last updated: 2026-07-13.
Decision dates by country: PL: 2026-01-04, IT: 2026-02-24, IE: 2026-01-09, ES: 2025-12-26

Condition(s): Non-small cell lung cancer (NSCLC)
Product: Pemetrexed EVER Pharma 25 mg/ml Konzentrat zur Herstellung einer Infusionslösung, KEYTRUDA 25 mg/mL concentrate for solution for infusion., Pemetrexed Glenmark 10 mg/ml Infusionslösung, STK-012, Carboplatin Hikma 10 mg/ml Konzentrat zur Herstellung einer Infusionslösung, PEMBROLIZUMAB

Primary endpoint: ORR is the proportion of subjects with confirmed complete response (CR) or confirmed partial response (PR) per blinded independent central review (BICR).
Endpoint(s): PFS is the time from randomization until the first documentation of disease progression per BICR or death due to any cause, whichever occurs first., ORR is the proportion of subjects with confirmed CR or confirmed PR per BICR., OS is the time from randomization until death due to any cause., Safety including but not limited to: TEAEs, SAEs, deaths, and clinical laboratory abnormalities per NCI CTCAE v5.0 except for CRS, which will be graded according to the ASTCT guidelines., Incidence of STK-012 antibodies and qualitative assessment of safety outcomes., PK characterization of STK-012 (eg, AUC, Cmax, Tmax, t1/2).

Source: https://euclinicaltrials.eu/ctis-public/view/2025-522632-14-00